EU clinical trial 2024-514583-12-00: The Role of Imaging Guided Surgery to Improve the Detection of Lymph Node metastases in Prostate Cancer Patients Treated with Radical Prostatectomy and Extended Pelvic Lymph Node Dissection
Sponsor: Ospedale San Raffaele S.r.l. (Hospital/Clinic/Other health care facility). Phase: Therapeutic exploratory (Phase II). Countries: Italy (ended).
Therapeutic area(s): Diseases [C] - Male Urogenital Diseases [C12]
Gender: Male. Age: 18-64 years, 65+ years. Enrolment: 100.
Status: Ended. Start date (EU): 2021-05-05. End date (EU): 2024-12-10. Decision date: 2024-11-11. Results received: Yes. Last updated: 2024-11-11.

Condition(s): Patients with prostate cancer (PCa) who are candidate to undergo surgical treatment with robot-assisted radical prostatectomy with a risk of lymph nodal invasion > 5% according to preoperative data
Product: [68GA]PSMA-HBED-CC, [99mTc]PSMA I&S

Primary endpoint: Rate of LNI observed at final pathology after 99mTc-PSMA-RGS (namely, histopathological evaluation of the lymph nodes done by a dedicated high-volume uropathologists, the results are typically available 10 days after surgery).

Source: https://euclinicaltrials.eu/ctis-public/view/2024-514583-12-00